EU clinical trial 2022-501797-19-00: Phase 1 Study of Allo-RevCAR01-T-CD123 in Patients With Selected CD123 Positive Hematologic Malignancies
Protocol code: AVC-201-01
Sponsor: AvenCell Europe GmbH (Pharmaceutical company). Phase: Human Pharmacology (Phase I)- First administration to humans. Countries: Germany (ongoing, recruiting), Netherlands (ongoing, recruiting).
Therapeutic area(s): Diseases [C] - Hemic and Lymphatic Diseases [C15]
Gender: Female, Male. Age: 18-64 years, 65+ years. Enrolment: 80.
Status: Ongoing, recruiting. Start date (EU): 2023-07-13. Decision date: 2023-06-16. Results received: No. Last updated: 2026-03-12.
Decision dates by country: DE: 2023-07-24, NL: 2023-11-22

Condition(s): Acute Myeloid Leukemia (AML)

Source: https://euclinicaltrials.eu/ctis-public/view/2022-501797-19-00